EU clinical trial 2022-501763-40-00: A Phase 3, Randomized, Double-blind Study to Evaluate the Safety and Efficacy of Emtricitabine and Tenofovir Alafenamide (F/TAF) Fixed-Dose Combination Once Daily for Pre-Exposure Prophylaxis in Men and Transgender Women Who Have Sex with Men and Are At Risk of HIV-1 Infection.
Protocol code: GS-US-412-2055
Sponsor: Gilead Sciences Inc. (Pharmaceutical company). Phase: Therapeutic confirmatory (Phase III). Countries: Italy (ended), Denmark (ended), Spain (ended), France (ended), Austria (ended), Germany (ended), Ireland (ended).
Therapeutic area(s): Diseases [C] - Virus Diseases [C02]
Gender: Male. Age: 18-64 years, 65+ years. Enrolment: 2090.
Status: Ended. Start date (EU): 2016-12-13. End date (EU): 2026-07-29. End date: 2026-07-30. Decision date: 2023-06-07. Results received: No. Last updated: 2026-03-31.
Decision dates by country: DK: 2023-06-08, ES: 2023-06-08, DE: 2023-06-14, AT: 2023-06-13, IE: 2023-06-07, IT: 2023-06-09, FR: 2023-06-13

Condition(s): Pre-Exposure Prophylaxis of HIV-1 Infection
Product: Descovy 200 mg/25 mg film-coated tablets

Primary endpoint: The primary endpoint will be the incidence of HIV-1 infection per 100 person years (PY) when all participants have a minimum follow up of 48 weeks and at least 50% of the participants have 96 weeks of follow up after randomization. HIV-1 infection is defined by 1 or more of the following criteria of contributing HIV tests performed via central lab or local lab:, Serologic evidence of seroconversion (reactive screening HIV antigen [Ag]/antibody [Ab] or Ab test, confirmed by reactive HIV-1/HIV-2 differentiation assay), excluding HIV vaccinated participants, or, Virologic evidence of HIV-1 infection (positive qualitative HIV-1 RNA test or any detectable quantitative HIV-1 RNA test), or, Evidence of acute HIV-1 infection (reactive p24 Ag or positive qualitative or quantitative RNA, in the absence of a reactive HIV-1 Ab test results)
Endpoint(s): The percent change from baseline in hip BMD at Week 48 in a subset of participants, The percent change from baseline in spine BMD at Week 48 in a subset of participants, Assessment of renal biomarkers at Week 48, Percent change from baseline in urine beta-2-microglobulin to creatinine ratio, Percent change from baseline in urine RBP to creatinine ratio, Distribution of UP and UPCR categories, The change from baseline in serum creatinine at Week 48, The incidence of HIV-1 infection (as per Appendix 11.6) per 100 PY when all participants have 96 weeks of follow up after randomization, The percent change from baseline in hip and spine BMD at Week 96 in the blinded phase in a subset of participants, Assessment of renal biomarkers at Week 96 in the blinded phase, Percent change from baseline in urine beta-2-microglobulin to creatinine ratio, Percent change from baseline in urine RBP to creatinine ratio, Distribution of UP and UPCR categories, The change from baseline in serum creatinine at Week 96 in the blinded phase, The incidence of treatment-emergent adverse events (AEs) and laboratory toxicities

Source: https://euclinicaltrials.eu/ctis-public/view/2022-501763-40-00